EU clinical trial 2023-504782-23-00: A study of how CagriSema works on appetite in people with excess body weight
Protocol code: NN9838-4944
Sponsor: Novo Nordisk A/S (Pharmaceutical company). Phase: Human Pharmacology (Phase I)- Other. Countries: Germany (ended).
Therapeutic area(s): Diseases [C] - Nutritional and Metabolic Diseases [C18]
Gender: Female, Male. Age: 18-64 years, 65+ years. Enrolment: 150.
Status: Ended. Start date (EU): 2024-02-09. End date (EU): 2025-12-08. Decision date: 2023-12-12. Results received: No. Last updated: 2025-09-30.

Condition(s): Obesity

Source: https://euclinicaltrials.eu/ctis-public/view/2023-504782-23-00